EU clinical trial 2023-505541-99-00: A Phase 2b, Randomized, Double-Blind, Multicenter, Placebo-Controlled Study to Evaluate the Efficacy, Safety, and Pharmacokinetics of Treprostinil Palmitil Inhalation Powder in Participants with Pulmonary Arterial Hypertension
Protocol code: INS1009-202
Sponsor: Insmed Inc. (Pharmaceutical company). Phase: Therapeutic exploratory (Phase II). Countries: Belgium (ended), Italy (ended), Spain (ended), Denmark (ended), Austria (ended), Germany (ended).
Therapeutic area(s): Diseases [C] - Respiratory Tract Diseases [C08]
Gender: Female, Male. Age: 18-64 years, 65+ years. Enrolment: 23.
Status: Ended. Start date (EU): 2022-06-28. End date (EU): 2025-03-05. Decision date: 2024-06-19. Results received: Yes. Last updated: 2025-04-02.
Decision dates by country: AT: 2024-06-24, IT: 2024-07-02, BE: 2024-06-21, DE: 2024-06-20, ES: 2024-06-20, DK: 2024-06-19

Condition(s): Pulmonary Arterial Hypertension
Product: TREPROSTINIL PALMITIL INHALATION POWDER, Placebo (inhalation powder capsules) containing 1 of 3 dosage strengths of TPIP (80 μg, 160 μg, or 320 μg), TREPROSTINIL PALMITIL INHALATION POWDER, TREPROSTINIL PALMITIL INHALATION POWDER

Primary endpoint: Change from Baseline in PVR at Week 16
Endpoint(s): Change from Baseline in 6MWT distance at Week 5, Week 10, and Week 16, Percent change from Baseline in 6MWT distance at Week 5, Week 10 and Week 16, Frequency of AEs and changes from Baseline in clinical laboratory evaluations, vital signs, ECG, and physical examination over the 16-week treatment period, Plasma PK parameters of TP and TRE, including Cmax, tmax, AUC24, AUC∞, AUClast, CL/F, Vd/F, and t½, on Day 1 and at Week 10, Change from Baseline in the concentration of NT-proBNP at Week 5, Week 10 and Week 16

Source: https://euclinicaltrials.eu/ctis-public/view/2023-505541-99-00